EU clinical trial 2023-503595-24-00: A research study looking at how the compound NNC0194-0499 works with birth control pills in women not able to bear children.
Protocol code: NN9500-4619
Sponsor: Novo Nordisk A/S (Pharmaceutical company). Phase: Human Pharmacology (Phase I)- First administration to humans. Countries: Austria (ended).
Therapeutic area(s): Diseases [C] - Digestive System Diseases [C06]
Gender: Female. Age: 18-64 years, 65+ years. Enrolment: 30.
Status: Ended. Start date (EU): 2023-12-14. End date (EU): 2024-12-30. Decision date: 2023-07-17. Results received: No. Last updated: 2024-03-01.

Condition(s): Healthy volunteers (Non-alcoholic steatohepatitis (NASH))

Source: https://euclinicaltrials.eu/ctis-public/view/2023-503595-24-00